EU clinical trial 2023-506785-32-00: EMBER: A Study of LY3484356 in Patients with Breast or Other Non-Breast Cancers
Protocol code: J2J-MC-JZLA
Sponsor: Eli Lilly & Co. (Pharmaceutical company). Phase: Human Pharmacology (Phase I)- Other. Countries: Spain (ongoing, recruitment ended), France (ongoing, recruitment ended), Belgium (ongoing, recruitment ended).
Therapeutic area(s): Diseases [C] - Neoplasms [C04]
Gender: Female, Male. Age: 18-64 years, 65+ years. Enrolment: 12.
Status: Ongoing, recruitment ended. Start date (EU): 2020-09-11. Decision date: 2024-04-26. Results received: No. Last updated: 2026-02-24.
Decision dates by country: ES: 2024-04-26, FR: 2024-05-02, BE: 2024-04-30

Condition(s): Breast Cancer, Endometrial cancer

Source: https://euclinicaltrials.eu/ctis-public/view/2023-506785-32-00